EU clinical trial 2024-519961-23-00: Characterization of cerebral amyloid deposition with 18F-Flutemetamol PET and of glucose metabolism with 18F-FDG PET in individuals enrolled in the ALFA project
Sponsor: Barcelonabeta Brain Research Center (Laboratory/Research/Testing facility). Phase: Therapeutic use (Phase IV). Countries: Spain (authorised, recruiting).
Therapeutic area(s): Health Care [N] - Population Characteristics [N01]
Gender: Female, Male. Age: 18-64 years, 65+ years. Enrolment: 400.
Status: Authorised, recruiting. Start date (EU): 2025-01-25. Decision date: 2025-01-20. Results received: No. Last updated: 2026-05-13.

Condition(s): Alzheimer's Disease
Product: BARNASCAN 3000 MBq/ml solución inyectable, VIZAMYL 400 MBq/mL solution for injection

Primary endpoint: Participants with a mean cortex activity SUVr (cerebellar cortex) over 1.56 in 18F-Flutemetamol PET will be classified as positive and, otherwise, as negative for cerebral amyloid deposition. Prevalence of positive 18F-Flutemetamol PET will be determined by age, sex, APOE genotype, and familiar history of AD.

Source: https://euclinicaltrials.eu/ctis-public/view/2024-519961-23-00